EU clinical trial 2024-511047-26-01: DIFFUSION CHARACTERISTICS OF LETIBOTULINUMTOXIN A IN COMPARISON TO ONA AND ABO-BONTA
Protocol code: 20231129
Sponsor: Hamburg University (Educational Institution). Phase: Therapeutic use (Phase IV). Countries: Germany (authorised, recruitment pending).
Therapeutic area(s): Analytical, Diagnostic and Therapeutic Techniques and Equipment [E] - Therapeutics [E02]; Not possible to specify
Gender: Female, Male. Age: 18-64 years, 65+ years. Enrolment: 30.
Status: Authorised, recruitment pending. Decision date: 2024-06-07. Results received: No. Last updated: 2024-06-07.

Condition(s): Stable health without uncontrolled systemic diseases; Healthy skin testing area (forehead); Moderate to severe forehead wrinkling (in motion); Uniform sweating activity and no areas of anhidrosis (under standardized sweating conditions)
Product: BOTOX 100 Allergan-Einheiten Pulver zur Herstellung einer Injektionslösung, Letybo 50 Einheiten Pulver zur Herstellung einer Injektionslösung, Dysport® 300 Einheiten Pulver zur Herstellung einer Injektionslösung

Primary endpoint: Maximum anhidrosis area; measured by the halo of anhidrosis
Endpoint(s): Range of anhidrosis at all other measured time points; Wrinkle Thickness (No Movement / Maximum Tension) measured by Live Evaluation and Evaluation via Standardized Photography; Area under the curve (anhidrosis area) within a period of 6 months; Patient satisfaction; Eyebrow position

Source: https://euclinicaltrials.eu/ctis-public/view/2024-511047-26-01